EU clinical trial 2024-519860-41-00: A study to investigate how different tablet types of balinatunfib and food will influence the absorption of balinatunfib in blood in healthy adult participants
Protocol code: BDR18228
Sponsor: Sanofi-Aventis Recherche & Developpement (Pharmaceutical company). Phase: Human Pharmacology (Phase I)- Other. Countries: Belgium (ended).
Therapeutic area(s): Diseases [C] - Immune System Diseases [C20]
Gender: Female, Male. Age: 18-64 years. Enrolment: 36.
Status: Ended. Start date (EU): 2025-06-02. End date (EU): 2025-08-01. Decision date: 2025-05-26. Results received: No. Last updated: 2025-07-01.

Condition(s): Immune system diseases

Source: https://euclinicaltrials.eu/ctis-public/view/2024-519860-41-00